EU clinical trial 2024-513862-20-00: A Multicentre, Single-Arm, Phase 3b Study to Assess Changes in Symptoms in Participants With Chronic Rhinosinusitis With Nasal Polyposis Initiating Treatment with Tezepelumab (ESSENCE)
Protocol code: D5242C00002
Sponsor: AstraZeneca AB (Pharmaceutical company). Phase: Therapeutic confirmatory (Phase III). Countries: France (ongoing, recruitment ended), Spain (ongoing, recruitment ended), Hungary (ongoing, recruitment ended), Poland (ongoing, recruitment ended), Germany (ongoing, recruitment ended), Bulgaria (ongoing, recruitment ended), Italy (ongoing, recruitment ended).
Therapeutic area(s): Diseases [C] - Otorhinolaryngologic Diseases [C09]; Diseases [C] - Respiratory Tract Diseases [C08]
Gender: Female, Male. Age: 18-64 years, 65+ years. Enrolment: 356.
Status: Ongoing, recruitment ended. Start date (EU): 2025-03-26. Decision date: 2025-02-24. Results received: No. Last updated: 2026-05-20.
Decision dates by country: HU: 2025-02-26, PL: 2025-03-02, BG: 2025-02-27, FR: 2025-03-05, ES: 2025-02-27, DE: 2025-03-05, IT: 2025-03-05

Condition(s): Chronic Rhinosinusitis with Nasal Polyposis
Product: Tezspire 210 mg solution for injection in pre-filled syringe

Primary endpoint: Change from baseline in nasal congestion measured by the NCS at Week 24., Change from baseline in sino-nasal symptoms measured by SNOT-22 total score at Week 24.
Endpoint(s): Proportion of NCS responders (minimal clinically important difference [MCID] from baseline = 1.0) at each collected timepoint. • Description of time to first response for NCS by analysing data at all collected timepoints. • Change from baseline in NCS at each collected timepoint., Proportion of SNOT-22 responders (MCID from baseline = -8.9) at each collected timepoint. • Description of time to first response for SNOT-22 by analysing data at all collected timepoints. • Change from baseline in SNOT-22 at each collected timepoint., Change from baseline visit in NB measured by: 1. PNIF 2. VAS-NB 3. Proportion of PNIF, VAS-NB responders, 4. Description of time to first response for PNIF, VAS NB, Change from baseline in loss of smell score evaluated by: 1. UPSIT or Sniffin Sticks 2. VAS-Taste 3. VAS-Smell 4. Proportion of UPSIT, Sniffin sticks, VAS-Smell responders 5. Proportion of participants with a reduction in VAS-Taste score from baseline 6. Description of time to first response for UPSIT/Sniffin sticks, VAS Smell , improvement in VAS-Taste, Change from baseline in sleep as evaluated by: 1. PSQI total score 2. SNOT-22 Sleep domain score 3. VAS-Sleep 4. Proportion of PSQI, SNOT-22 Sleep domain responders 5. Proportion of participants with any improvement in VAS Sleep from baseline 6. Description of time to first response for PSQI, SNOT-22 Sleep domain, improvement for VAS-Sleep, Change from baseline in total NPS evaluated by nasal endoscopy. Summary measures: mean (SD) and distribution of NPS as assessed by above measures will be described at each visit. Other analysis: Proportion of responders 2. Proportion of NPS responders (MCID from baseline = 1.0) at Weeks 2 and 24., Change from baseline in NPQ score Summary measures: mean (SD) and distribution of NPQ scores will be described. Other analyses 3. Proportion of NPQ responders (MCID from baseline = 7.0) 4. Description of time to first response for NPQ by analysing data collected at each specified timepoint., Change from baseline in TSS Summary measures: mean (SD) and distribution of TSS will be described. Other analyses 3. Proportion of TSS responders (MCID from baseline = 4.0) 4. Description of time to first response for TSS by analysing data at all collected timepoints., Change from baseline in NP severity as measured by VAS Overall symptoms 3. Proportion of VAS Overall symptom responders (MCID from baseline = 2.5) 4. Description of time to first response for VAS-Overall symptom by analysing data at all collected timepoints, Proportion of participants who respond as ‘well controlled’ or ‘completely controlled’ NP symptoms to the NP control question Other analysis: time to first response • Description of time to first response for NP control by analysing data at all collected timepoints.

Source: https://euclinicaltrials.eu/ctis-public/view/2024-513862-20-00